EU clinical trial 2023-505241-10-00: A phase IIa, open label, single centre study to assess the safety, tolerability, pharmacokinetics, pharmacodynamics and preliminary efficacy of orally dosed MBF-015 in Huntington's disease patients
Protocol code: MBF-015CT-02
Sponsor: Medibiofarma S.L. (Pharmaceutical company). Phase: Therapeutic exploratory (Phase II). Countries: Spain (ended).
Therapeutic area(s): Diseases [C] - Nervous System Diseases [C10]
Gender: Female, Male. Age: 18-64 years. Enrolment: 10.
Status: Ended. Start date (EU): 2024-01-30. End date (EU): 2024-12-04. Decision date: 2023-09-11. Results received: Yes. Last updated: 2024-06-03.

Condition(s): Huntington's disease

Primary endpoint: The primary endpoint of the study is safety and tolerability of MBF-015 administration for 28 days from baseline to end of the follow-up period at Day 43. Number and severity of AEs reported including Clinically Significant Changes in vital signs, physical examination, Laboratory Measurements, ECGs, and Columbia-Suicide Severity Rating Scale (C-SSRS).
Endpoint(s): • Plasma: Cmax, Tmax, Area under curve (AUC) and Cmin in plasma at Day 1-2 and Day 28, and single-point concentration on Day 43., • CSF: concentration of MBF-015 on Day 28 at [+ 4h] post-dose., • Change from baseline of neuronal biomarkers including Nfl levels measured in CSF and/or blood at Day 28., • Change from baseline of absolute delta, theta, alpha and beta power, aperiodic exponent, offset and global coherence., • Change from baseline of the strength of functional connectivity across the nodes comprising the default mode network and the fronto-parietal network. at Day 28., • Change from baseline of the total PD-CRS score at Day 28., • Change from baseline in the UHDRS total motor score (UHDRS-TMS) at Day 28 (EoT, V4), and day 43 (EoS, V5)., • Change from baseline in the UHDRS Functional assessment checklist at Day 28 (EoT, V4)., • Change from baseline in the UHDRS independence scale at Day 28 (EoT, V4), and day 43 (EoS, V5)., • Change from baseline in the UHDRS total functional capacity (UHDRS-TFC) at Day 28 (EoT, V4), and day 43 (EoS, V5)., • Change from baseline in the Stroop word reading test (SWR) at Day 28 (EoT, V4), and day 43 (EoS, V5)., • Change from baseline in the Symbol Digit Modalities Test (SDMT) at Day 28 (EoT, V4), and day 43 (EoS, V5)., • Change from baseline in the composite UHDR score (c-UHDRS)., • Change from baseline of apathy severity score in the PBA-s at Day 28 (EoT, V4), and day 43 (EoS, V5)., • Change from baseline of the different PD-CRS subtests at day 28., • Change from baseline of histone activity or H3K9 acetylation or selected mRNAs in blood, at Day 28 (EoT, V4), and day 43 (EoS, V5).

Source: https://euclinicaltrials.eu/ctis-public/view/2023-505241-10-00